EU clinical trial 2022-501157-36-00: Early Sedation with Dexmedetomidine vs. Placebo in Older Ventilated Critically Ill Patients
Protocol code: V1.0
Sponsor: Monash University (Educational Institution). Phase: Therapeutic use (Phase IV). Countries: Netherlands (ended), Ireland (authorised, recruitment pending), Finland (authorised, recruitment pending), Germany (ongoing, recruiting), Spain (authorised, recruitment pending).
Therapeutic area(s): Analytical, Diagnostic and Therapeutic Techniques and Equipment [E] - Anesthesia and Analgesia [E03]
Gender: Female, Male. Age: 65+ years. Enrolment: 760.
Start date (EU): 2024-02-07. Decision date: 2023-10-04. Results received: No. Last updated: 2026-05-25.
Decision dates by country: IE: 2023-06-10, NL: 2023-04-10, FI: 2025-01-15, DE: 2024-08-06, ES: 2026-05-25

Condition(s): Critically ill patients who are dependent on high level medical care including mechanical ventilation, vasopressors and sedative/analgesic medication
Product: Placebo is 2 ml of saline manufactured by EVER Pharma according to the same GMP manufacturing certificate, Dexmedetomidine EVER Pharma 100 micrograms/ml concentrate for solution for infusion

Primary endpoint: The study primary outcome is 90-day all-cause mortality.
Endpoint(s): • Number of days alive and free of coma and delirium at 28 days, • Number of days alive and ventilator free at 28 days, • Major Adverse Kidney Events at 28 days (Mortality + Acute Kidney Injury > stage II, defined by Kidney Disease Improving Global Outcome (KDIGO) definition, • Duration of mechanical ventilation in survivors, • Hospital length of stay in survivors

Source: https://euclinicaltrials.eu/ctis-public/view/2022-501157-36-00